EU clinical trial 2024-513528-41-02: The Effect of Mitapivat on Cerebral Perfusion and Oxygen Metabolism in Sickle Cell Disease
Sponsor: Amsterdam UMC Stichting (Hospital/Clinic/Other health care facility). Phase: Therapeutic confirmatory (Phase III). Countries: Netherlands (authorised, recruitment pending).
Therapeutic area(s): Diseases [C] - Hemic and Lymphatic Diseases [C15]
Gender: Female, Male. Age: 18-64 years, 65+ years. Enrolment: 20.
Status: Authorised, recruitment pending. Decision date: 2025-06-02. Results received: No. Last updated: 2026-05-08.

Condition(s): Sickle cell anaemia
Product: MITAPIVAT

Primary endpoint: To assess the effect of mitapivat on the cerebral oxygen metabolism (CBF) as measured per MRI at 3 and 12 months
Endpoint(s): CBF will be measured by PCASL in SCD at 3 and 12 months, CVR will be assessed by the administration of acetazolamide which is a carbonic anhydrase inhibitor that produces a powerful cerebral vasodilatory effect comparable to 5% inhaled CO2 at 3 and 12 months, Cerebral metabolic rate of oxygen (CMRO2) is measured by MRI technique by T2 relaxation under spin tagging (TRUST) at 3 and 12 months, TRV, left atrial dilatation and LVEF + global longitudinal strain (GLS) and left ventricular end diastolic diamterer (LVED) hyperdynamic circulation as assed by trans-thoracic echocardiography after 3 and 12 months

Source: https://euclinicaltrials.eu/ctis-public/view/2024-513528-41-02